EU clinical trial 2023-503999-24-00: A Phase III, double-blind, placebo-controlled, Randomized, Multicenter, International Study of Durvalumab Plus Oleclumab and Durvalumab Plus Monalizumab in Patients With Locally Advanced (Stage III), Unresectable Non-small Cell Lung Cancer (NSCLC) Who Have Not Progressed Following Definitive, Platinum-Based Concurrent Chemoradiation Therapy (PACIFIC-9)
Protocol code: D9078C00001
Sponsor: AstraZeneca AB (Pharmaceutical company). Phase: Therapeutic confirmatory (Phase III). Countries: Spain (ongoing, recruitment ended), France (ongoing, recruitment ended), Germany (ongoing, recruitment ended), Italy (ongoing, recruitment ended), Poland (ongoing, recruitment ended), Portugal (ongoing, recruitment ended).
Therapeutic area(s): Diseases [C] - Neoplasms [C04]
Gender: Female, Male. Age: 18-64 years, 65+ years. Enrolment: 437.
Status: Ongoing, recruitment ended. Start date (EU): 2022-06-01. Decision date: 2024-02-13. Results received: No. Last updated: 2026-04-14.
Decision dates by country: PL: 2024-06-10, DE: 2024-06-11, PT: 2024-06-05, ES: 2024-02-13, FR: 2024-06-07, IT: 2024-02-26

Condition(s): Patients With Locally Advanced (Stage III), Unresectable Non-small Cell Lung Cancer (NSCLC)
Product: SODIUM CHLORIDE, MYCOPHENOLATE MOFETIL, GLUCOSE, Oleclumab, MYCOPHENOLATE MOFETIL, IMFINZI 50 mg/mL concentrate for solution for infusion., Monalizumab, IMFINZI 50 mg/mL concentrate for solution for infusion., INFLIXIMAB

Primary endpoint: Progression Free Survival (PFS) as assessed by BICR, per RECIST 1.1. Up to 5 years after first patient randomized.

Source: https://euclinicaltrials.eu/ctis-public/view/2023-503999-24-00